EU clinical trial 2024-518065-10-00: A Randomized Phase II Study of Systemic Chemotherapy with or without HAI FUDR/Dexamethasone in Patients with Unresectable Intrahepatic Cholangiocarcinoma
Protocol code: 20-348
Sponsor: Memorial Sloan Kettering Cancer Center (Hospital/Clinic/Other health care facility). Phase: Therapeutic exploratory (Phase II). Countries: Netherlands (ongoing, recruiting).
Therapeutic area(s): Diseases [C] - Neoplasms [C04]
Gender: Female, Male. Age: 18-64 years, 65+ years. Enrolment: 60.
Status: Ongoing, recruiting. Start date (EU): 2025-02-26. Decision date: 2024-11-08. Results received: No. Last updated: 2026-07-24.

Condition(s): Unresectable intrahepatic cholangiocarcinoma

Primary endpoint: Progression-free survival
Endpoint(s): 1. Compare the overall survival in first-line HAI FUDR/Dex in combination with GemOx versus systemic GemOx only., 2. Estimate the overall response rate (CR+PR) between treatment groups., 3. Estimate the time to first recurrence patterns between treatment groups., 4. Describe the toxicity rates separately for each treatment groups., Define the mutational pattern of IHC and determine the extent to which genomic features and intratumoral heterogeneity correlate with treatment response and survival.

Source: https://euclinicaltrials.eu/ctis-public/view/2024-518065-10-00